EU clinical trial 2023-506125-10-00: A Phase 3 Study Comparing Daratumumab, VELCADE (bortezomib), Lenalidomide, and Dexamethasone (D-VRd) vs VELCADE, Lenalidomide, and Dexamethasone (VRd) in Subjects with Previously Untreated Multiple Myeloma who are Eligible for High-dose Therapy - EMN17/54767414MMY3014
Protocol code: EMN1754767414MMY3014
Sponsor: European Myeloma Network B.V., Emn Trial Office S.r.l. Impresa Sociale (Patient organisation/association, Laboratory/Research/Testing facility). Phase: Therapeutic confirmatory (Phase III). Countries: Denmark (ongoing, recruitment ended), Italy (ongoing, recruitment ended), Poland (ongoing, recruitment ended), Czechia (ongoing, recruitment ended), Belgium (ongoing, recruitment ended), Netherlands (ongoing, recruitment ended), Spain (ongoing, recruitment ended), Greece (ongoing, recruitment ended), Norway (ongoing, recruitment ended), France (ongoing, recruitment ended), Germany (ongoing, recruitment ended).
Therapeutic area(s): Diseases [C] - Neoplasms [C04]
Gender: Female, Male. Age: 18-64 years, 65+ years. Enrolment: 688.
Status: Ongoing, recruitment ended. Start date (EU): 2018-12-24. Decision date: 2024-02-29. Results received: No. Last updated: 2026-08-03.
Decision dates by country: BE: 2024-03-01, FR: 2024-03-01, NO: 2024-02-29, CZ: 2024-03-04, ES: 2024-03-04, PL: 2024-03-15, GR: 2024-04-09, DK: 2024-03-01, DE: 2024-03-01, IT: 2024-03-05, NL: 2024-02-29

Condition(s): Multiple Myeloma
Product: DARZALEX 1800 mg solution for injection, Revlimid 10 mg hard capsules, Revlimid 15 mg hard capsules, Lenalidomide Mylan 10 mg hard capsules, Revlimid 15 mg hard capsules, Revlimid 5 mg hard capsules, DEXAMETHASONE, Lenalidomide Mylan 15 mg hard capsules, Lenalidomide Mylan 5 mg hard capsules, Revlimid 5 mg hard capsules, VELCADE 3.5 mg powder for solution for injection, Revlimid 10 mg hard capsules

Primary endpoint: PFS is defined as the time from the date of randomization to the date of disease progression or death due to any cause, whichever occurs first.
Endpoint(s): Post-consolidation MRD negativity rate, defined as the proportion of subjects who achieve MRD negativity (at or below the threshold of 10^- 5) at the end of consolidation., Overall MRD negativity rate, defined as the proportion of subjects who achieve MRD negativity (10^-5) at any time during the study., Overall ORR, rate of VGPR or better, rate of CR or better, and rate of sCR, defined as the proportions of subjects who achieved PR or better (or VGPR or better, or CR or better, or sCR) per the IMWG criteria at post-induction, post-transplant, post-consolidation, and overall., Progression-free survival on the next line of therapy (PFS2) is defined as the time from randomization to progression on the next line of treatment or death, whichever comes first., OS, measured from the date of from randomization to the date the subject's death., Time to response (PR or better), time to CR/sCR are defined as the time from randomization to date of initial response (or initial CR/sCR,)., Duration of response (PR or better), duration of CR, duration of sCR, and duration of MRD-negative status, are calculated from the date of the initial documentation of a response (PR or better), or CR or better, or sCR, or MRD-negative status to the date of the first documented evidence of disease progression, as defined in the IMWG criteria, or death due to PD whichever occurs first., Pharmacokinetic concentrations of daratumumab (further defined in Section 9.3)., Immunogenicity of daratumumab and rHuPH20, Change in HRQoL, symptoms, and functioning using two European Organization for Research and Treatment of Cancer (EORTC) questionnaires and the EuroQol Group Five Dimensions Five Levels Questionnaires (EQ-5D-5L)., Stem cell yield after mobilization (further defined in Section 9.1.3.2)., Time to engraftment post ASCT defined as absolute neutrophil count (ANC) ≥0.5 x 10^9/L and platelet count ≥20 x 10^9/L.

Source: https://euclinicaltrials.eu/ctis-public/view/2023-506125-10-00